EU clinical trial 2024-517619-65-00: Effect of low-dose Interferon-alfa2a on perioperative immune suppression
Sponsor: Region Sjaelland (Hospital/Clinic/Other health care facility). Phase: Therapeutic exploratory (Phase II). Countries: Denmark (ongoing, recruiting).
Therapeutic area(s): Diseases [C] - Neoplasms [C04]; Diseases [C] - Digestive System Diseases [C06]
Gender: Female, Male. Age: 18-64 years, 65+ years. Enrolment: 68.
Status: Ongoing, recruiting. Start date (EU): 2023-08-28. Decision date: 2024-09-27. Results received: No. Last updated: 2026-01-20.

Condition(s): Colon cancer
Product: Pegasys 135 micrograms solution for injection in pre-filled syringe, Sodium Chloride Fresenius Kabi Italia 0.9 % Solution for infusion

Primary endpoint: • Differences in measures of lymphocytic subpopulations (FLOW) between intervention and placebo group, seen as a higher number of CD3, 4, 8 and HLA-positive cells in the intervention group, on the day of and the day after surgery. • Differences in tumor-infiltrating lymphocytes in the resected specimen at the tumor center and invasive margin between the intervention and placebo group. This will be analysed via immunohistochemistry with staining for CD3+, CD4+ and CD8+ T-cells.
Endpoint(s): A few of them: 1)Differences in measures of Quality of recovery (QoR-15) between intervention and placebo group, seen as a higher mean QoR in intervention group on the third and 12-16 post-operative day. 2) Differences in phenotype and clonality of tumor-infiltrating and circulating T cells between placebo and intervention group, analyzed via combined single-cell transcriptome and TCR sequencing. 3) Differences in tumor microenvironment in the resected specimen.

Source: https://euclinicaltrials.eu/ctis-public/view/2024-517619-65-00